EU clinical trial 2023-509917-35-00: A Phase 2, Randomised, Double-Blind, Placebo-Controlled, Proof-of-Concept Study to Evaluate the Efficacy, Safety, and Tolerability, and Effects on Tumour Biomarkers of the NOX1/4 Inhibitor Setanaxib, when Administered with the PD-1 Inhibitor Pembrolizumab, in Patients with Recurrent or Metastatic Squamous Cell Carcinoma of the Head and Neck (SCCHN)
Protocol code: GSN000400
Sponsor: Calliditas Therapeutics Suisse S.A. (Pharmaceutical company). Phase: Therapeutic exploratory (Phase II). Countries: Spain (ended), Italy (ended), France (ended), Poland (ended).
Therapeutic area(s): Diseases [C] - Neoplasms [C04]
Gender: Female, Male. Age: 18-64 years, 65+ years. Enrolment: 48.
Status: Ended. Start date (EU): 2022-03-21. End date (EU): 2025-08-21. End date: 2025-08-22. Decision date: 2024-05-17. Results received: Yes. Last updated: 2025-03-14.
Decision dates by country: ES: 2024-05-17, PL: 2024-05-21, FR: 2024-05-22, IT: 2024-06-03

Condition(s): Recurrent or Metastatic Squamous Cell Carcinoma of the Head and Neck (SCCHN)
Product: Setanaxib, KEYTRUDA 25 mg/mL concentrate for solution for infusion, Placebo tablets setanaxib

Primary endpoint: Best percentage change in tumour size, defined as the best percentage change from Baseline in the sum of diameters of target lesions, as assessed by RECIST v1.1
Endpoint(s): PFS, defined as time from randomisation to the first documented disease progression per RECIST v1.1 or death due to any cause, whichever occurs first. PFS at 3, 6, and 12 months and median PFS will be summarised, Change from Baseline in CAFs level in tumour tissue, Change from Baseline in the number of CD8+ TILs and regulatory T-cells in tumour tissue

Source: https://euclinicaltrials.eu/ctis-public/view/2023-509917-35-00